EU clinical trial 2023-503984-41-00: A Prospective, double-blind, randomized, single centre trial to evaluate the rate of RAAS inhibitor withdrawal or down-titration in non-dialysis patients with CKD stage IIIB to Vrandomized to Patiromer or placebo
Sponsor: Mario Negri Institute For Pharmacological Research IRCCS (Laboratory/Research/Testing facility). Phase: Therapeutic confirmatory (Phase III). Countries: Italy (ended).
Therapeutic area(s): Diseases [C] - Nutritional and Metabolic Diseases [C18]
Gender: Female, Male. Age: 18-64 years, 65+ years. Enrolment: 1.
Status: Ended. Start date (EU): 2023-08-02. End date (EU): 2024-10-16. Decision date: 2023-06-27. Results received: Yes. Last updated: 2023-10-17.

Condition(s): Hyyperkalemia in CKD stage IIIB to V patients
Product: POLYSTYRENE SULFONATE, OMNIPAQUE 300 mg I/ml soluzione iniettabile, Placebo, Veltassa 8.4 g powder for oral suspension

Primary endpoint: Number of patients who withdraw or reduce RAAS inhibition therapy because of refractory hyperkalemia (serum K+ levels ≥ 5.5 mEq/L at two consecutive visits one-week apart) during the follow-up period
Endpoint(s): To compare between the two treatment groups serum potassium normalization (serum K+<5.0 mEq/L considered as a dichotomous endpoint) for at least two consecutive visits one week apart, To compare between the two treatment groups serum potassium levels considered as a continuous variable, To compare between the two treatment groups Markers of mineral metabolism (serum calcium, phosphate, magnesium, intact parathyroid hormone, 1,25-dihydroxyvitamin D serum levels, 24-hour urinary calcium, phosphate, magnesium excretion), To compare between the two treatment groups plasma renin activity and serum aldosterone levels and 24-hour urinary aldosterone excretion, To compare between the two treatment groups pH and Base Excess, To compare between the two treatment groups GFR decline (iohexol plasma clearance technique), To compare between the two treatment groups 24-hour albuminuria and proteinuria and 24-hour urinary albumin/creatinine (A/C) ratio and 24-hour urinary protein/creatinine (P/C) ratio, To compare between the two treatment groups urinary spot morning albumin/creatinine (A/C) ratio and protein/creatinine (P/C) ratio, To compare between the two treatment groups albumin, total protein, calcium, phosphate, magnesium, sodium and potassium fractional clearances, To compare between the two treatment groups need of renal replacement therapy because of ESRD, To compare between the two treatment groups need of SPS therapy, To compare between the two treatment groups fatal and non-fatal cardiovascular events, To compare between the two treatment groups treatment costs for the study drugs, dialysis therapy and treatment-related complications, To compare between the two treatment groups quality of life as assessed using the Italian versions of validated questionnaires such as the SF-12 questionnaire, To assess the safety between the two study groups occurrence of hypokalemia (K+<3.5 mEq/L) and/or hypomagnesemia (<1.41 mg/dL), To assess the safety between the two study groups study treatment withdrawal because of side effects or poor tolerability, To assess the safety between the two study groups serious and non-serious adverse events and treatment-related adverse events and any clinically relevant abnormality in routine laboratory tests

Source: https://euclinicaltrials.eu/ctis-public/view/2023-503984-41-00